EU clinical trial 2024-516074-29-01: Use of Isoprenaline with Epinephrine During Out-of-Hospital Cardiac Arrest with Non-Shockable Rhytm (EPISO)
Sponsor: Odense University Hospital (Hospital/Clinic/Other health care facility). Phase: Therapeutic confirmatory (Phase III). Countries: Denmark (authorised, recruitment pending).
Therapeutic area(s): Diseases [C] - Cardiovascular Diseases [C14]
Gender: Female, Male. Age: 18-64 years, 65+ years. Enrolment: 1178.
Status: Authorised, recruitment pending. Decision date: 2025-08-11. Results received: No. Last updated: 2025-08-11.

Condition(s): Cardiac arrest
Product: SODIUM CHLORIDE, ISOPRENALINE

Primary endpoint: Sustained return of spontaneous circulation of at least 20 minutes.
Endpoint(s): Conversion from non-shockable to shockable rhythm, Favorable neurological outcome at hospital discharge, ROSC at hospital arrival, Thirty-day survival, Favorable neurological outcome at 90 days.

Source: https://euclinicaltrials.eu/ctis-public/view/2024-516074-29-01